EU clinical trial 2024-514853-31-00: A STUDY TO EVALUATE THE SAFETY, TOLERABILITY, AND PHARMACOKINETICS OF COR-1389
Protocol code: COR1389-101
Sponsor: Corteria Pharmaceuticals (Pharmaceutical company). Phase: Human Pharmacology (Phase I)- First administration to humans. Countries: Germany (ongoing, recruiting).
Therapeutic area(s): Diseases [C] - Cardiovascular Diseases [C14]; Diseases [C] - Nutritional and Metabolic Diseases [C18]
Gender: Female, Male. Age: 18-64 years. Enrolment: 112.
Status: Ongoing, recruiting. Start date (EU): 2024-09-10. Decision date: 2024-09-04. Results received: No. Last updated: 2026-05-05.

Condition(s): Obesity / Right heart failure (healthy participants)

Source: https://euclinicaltrials.eu/ctis-public/view/2024-514853-31-00